EU clinical trial 2023-506440-16-00: A Phase I/II, open-label, dose escalation study to evaluate the safety of 2 doses of intravenous ATA-200, an adeno-associated viral vector carrying the human gamma-sarcoglycan gene, in patients with gamma-sarcoglycanopathy (limb-girdle muscular dystrophy LGMDR5, formerly LGMD2C).
Protocol code: ATA-003-GSAR
Sponsor: Atamyo Therapeutics (Pharmaceutical company). Phase: Phase I and Phase II (Integrated)- First administration to humans. Countries: France (authorised, recruitment pending), Italy (authorised, recruitment pending).
Therapeutic area(s): Diseases [C] - Musculoskeletal Diseases [C05]
Gender: Female, Male. Age: 0-17 years. Enrolment: 5.
Status: Authorised, recruitment pending. Decision date: 2024-02-20. Results received: No. Last updated: 2025-12-10.
Decision dates by country: IT: 2024-02-20, FR: 2024-03-11

Condition(s): limb-girdle muscular dystrophy type R5 (previously named LGMD2C)
Product: PREDNISOLONE, METHYLPREDNISOLONE, Rapamune 1 mg/mL oral solution, rAAV8-hSGCG

Primary endpoint: incidence of AEs recording throughout the study, incidence of clinically relevant abnormalities detection in vital signs, physical examination findings, vital signs, myalgia assessment, cardiac assessment, laboratory determinations
Endpoint(s): Efficacy: muscle Function Tests: North Star Assessment for Neuromuscular Disorders (NSAD) and Performance of the Upper Limb (PUL), Efficacy: timed Function Tests: 10-meter walk test (10MWT); 100-Meter Walk Test (100MWT); Time to Rise From Floor (RFF); 4-Stair climb test, Efficacy: muscle Strength Tests: Myotools and Hand Held Dynamometry (HHD), Efficacy: Imaging Assessments: Muscle Nuclear Magnetic Resonance Imaging (NMRI) and spectroscopy: quantitative NMRI (including fat-water separation, based MRI and NMRS) in the lower limbs, Efficacy: Respiratory assessments: Pulmonary function tests, including forced vital capacity (FVC), minimal inspiratory/expiratory pressure (MIP/MEP), sniff nasal inspiratory pressure (SNIP) test, Efficacy: Respiratory assessments: Respiratory questionnaire, Efficacy: Muscle Biopsy: Histological assessment, including centronucleation index and fibrosis assessment, Efficacy: Muscle Biopsy: VCN: quantification of vector copy number per diploid cell, Efficacy: Muscle Biopsy: SGCG transgene expression (at protein and mRNA levels), Efficacy: Muscle Biopsy: Quantification of human sarcolemmal SGCG-positive fibers by immunohistochemistry, Efficacy: Muscle Biopsy: Quantification of human alpha-sarcoglycan positive fibers by immunohistochemistry, Efficacy: Muscle Biopsy: Exploratory biomarkers, e.g., TMEM8 for regeneration, FN1 for fibrosis, and CD11b for inflammation, microRNA, Efficacy: Patient reported outcome and QoL: Fatigue Visual Analog Scale (VAS), Efficacy: Patient reported outcome and QoL: EQ-5D-Y and EQ-5D-Y proxy 1 questionnaires (based on patient age), Efficacy: Patient reported outcome and QoL: Daily activity living (ACTIVLIM neuromuscular scale), Efficacy: Patient reported outcome and QoL: Change in video outcomes capturing disease hallmarks, Efficacy: Biomarkers: Creatine kinase (CK), myomesin-3, circulating microRNA, Efficacy: Biomarkers: Blood and urine biobanking

Source: https://euclinicaltrials.eu/ctis-public/view/2023-506440-16-00